EU clinical trial 2025-522603-15-00: A Phase IIb, Monocentric, Non-Profit, Open-label Trial for the Intrathecal Administration of AAV9/AP4M1 for Hereditary Spastic Paraplegia Type 50 (SPG50)
Protocol code: AAV9/AP4M1-ITA-01
Sponsor: Azienda Socio Sanitaria Territoriale Papa Giovanni Xxiii (Hospital/Clinic/Other health care facility). Phase: Therapeutic exploratory (Phase II). Countries: Italy (authorised, recruitment pending).
Therapeutic area(s): Diseases [C] - Congenital, Hereditary, and Neonatal Diseases and Abnormalities [C16]; Diseases [C] - Nervous System Diseases [C10]
Gender: Female, Male. Age: 0-17 years, 18-64 years. Enrolment: 5.
Status: Authorised, recruitment pending. Decision date: 2026-02-06. Results received: No. Last updated: 2026-06-30.

Condition(s): Hereditary Spastic Paraplegia Type 50 (SPG50)
Product: Melpida

Primary endpoint: Change in total percent score of the eight Major Motor Milestones derived from the Gross Motor Function Measure (GMFM)-88 from baseline at W156.
Endpoint(s): Developmental Milestones – Bayley Scale of Infant and Toddler Develop-ment 3rd Edition (Bayley-3) Cognitive Domain – Change in Total Raw Score from Baseline at W156., Gross and Fine Motor Function (GMFM-88 full scale) – Change in Total Score from Baseline at W156., Disease Severity (Spastic Paraplegia Rating Scale [SPRS]) – Change in Total Score from Baseline at W156., Disease Severity (Clinical Global Impression [CGI-I]) – Change in Physician-assessed CGI-I from Baseline at W156., Differential Ability Scales, 2nd Edition (DAS-II) - Change in Total Score from Baseline at W156., Developmental Milestones (Developmental Quotients [DQs]) – Change in DQs for Gross Motor, Adaptive behavior and Cognitive Scores from Base-line., Axonal Damage (Plasma neurofilament light chain levels [NfL]) – Change in Plasma NfL levels from Baseline., Health Related Quality of Life (The Caregiver Priorities and Child Health In-dex of Life with Disabilities [CPCHILD]) – Change in Total Score from Base-line., Disease Severity (Parent-rated Global Impression [PGI-I]) – Change in Glob-al Impression as assessed by the primary caregiver from Baseline., Axonal Damage (Cerebrospinal fluid [CSF] neurofilament light chain levels [NfL]) – Change in CSF NfL levels from Baseline., Serum and/or Plasma and CSF biomarkers – Change in Biomarker Levels from Baseline., Developmental Milestones (Vineland Adaptive Behavior Scale 3rd Edition [Vineland-3]) – Change in Total Score from Baseline.

Source: https://euclinicaltrials.eu/ctis-public/view/2025-522603-15-00